EU clinical trial 2024-514139-50-00: C1071006 – AN OPEN-LABEL, 2-ARM, MULTICENTER, RANDOMIZED PHASE 3 STUDY TO EVALUATE THE EFFICACY AND SAFETY OF ELRANATAMAB (PF-06863135) + DARATUMUMAB + LENALIDOMIDE VERSUS DARATUMUMAB + BORTEZOMIB + LENALIDOMIDE + DEXAMETHASONE IN TRANSPLANT-INELIGIBLE PARTICIPANTS WITH NEWLY DIAGNOSED MULTIPLE MYELOMA
Protocol code: C1071006
Sponsor: Pfizer Inc. (Pharmaceutical company). Phase: Therapeutic confirmatory (Phase III). Countries: France (ongoing, recruiting), Germany (ongoing, recruiting), Netherlands (ongoing, recruiting), Finland (ongoing, recruiting), Austria (ongoing, recruiting), Poland (ongoing, recruiting), Denmark (ended), Belgium (authorised, recruitment pending), Czechia (ongoing, recruiting), Italy (ongoing, recruiting), Spain (ongoing, recruiting), Greece (ongoing, recruiting).
Therapeutic area(s): Diseases [C] - Neoplasms [C04]
Gender: Female, Male. Age: 18-64 years, 65+ years. Enrolment: 444.
Start date (EU): 2022-11-14. Decision date: 2024-07-31. Results received: No. Last updated: 2026-06-26.
Decision dates by country: GR: 2024-10-18, FR: 2024-08-05, PL: 2024-08-04, FI: 2024-08-05, AT: 2024-08-05, DE: 2024-08-02, ES: 2024-08-01, NL: 2024-07-31, DK: 2024-07-31, CZ: 2024-08-01, IT: 2024-08-06, BE: 2024-07-31

Condition(s): Multiple myeloma
Product: ELRANATAMAB, DARZALEX 1800 mg solution for injection, VELCADE 3.5 mg powder for solution for injection, Dexamethasone 0.5mg Tablets, Zelvina 25 mg hard capsules, Privigen 100 mg/ml solution for infusion, Nodexon 20 mg tabletės, Nodexon 20 mg tabletės, Zelvina 10 mg hard capsules, Nodexon 20 mg tabletid, Nodexon 20 mg tabletes, Dexamethasone 4 mg tablets, Zelvina 5 mg hard capsules, Zelvina 15 mg hard capsules, Zelvina 2.5 mg hard capsules

Primary endpoint: Part 1: DLTs during the DLT observation period:For all dose levels (DLs) except DL F: From the first priming dose of elranatamab in the 2 Step-up Priming Dose Period until 28 days (± visit windows) from the first administration of the EDR combination., For DL F: 28 days (± visit windows) from the day of the first full dose of elranatamab (76 mg) in combination with daratumumab (D) and lenalidomide (R.)., Part 2: MRD negative CR rate (central lab) at 12 months after randomization per IMWG as assessed via next generation sequencing (NGS), PFS per IMWG
Endpoint(s): Part 1: Adverse events (AEs) as characterized by type, frequency, severity (as graded by National Cancer Institute Common Terminology Criteria for Adverse Events [NCI CTCAE] v5.0), timing, seriousness, and relationship to study treatment. Severity of cytokine release syndrome (CRS) and immune effector cell-associated neurotoxicity syndrome (ICANS) will be graded according to American Society for Transplantation and Cellular Therapy (ASTCT) criteria., Laboratory abnormalities as characterized by type, frequency, severity (as graded by NCI CTCAE v5.0), and timing., Objective response rate (ORR) and complete response rate (CRR,), per International Myeloma Working Group (IMWG) response criteria as determined by investigator., Time to event endpoints: time to response (TTR, ), duration of response (DOR, ), duration of complete response (DOCR) and progression-free survival (PFS) per IMWG response criteria as determined by investigator, and overall survival (OS;);, • Minimal residual disease (MRD) negative CR rate (central laboratory) per IMWG sequencing criteria., Predose and post dose concentrations of elranatamab against elranatamab, Anti-drug antibodies (ADAs) and neutralizing antibodies (NAbs) against elranatamab, Predose concentrations of daratumumab and lenalidomide, Part 2 Key Secondary: OS, Secondary: Overall MRD negative CR rate per IMWG, Duration of MRD negative CR per IMWG, PFS and progression-free survival on next line of therapy (PFS2) by investigator per IMWG, ORR, CRR, TTR, DOR, and DOCR per IMWG, AEs as characterized by type, frequency, severity (as graded by NCI CTCAE v5.0), timing, seriousness, and relationship to study treatment. The severity of CRS and ICANS will be graded according to ASTCT criteria (Lee, 2019)., Laboratory abnormalities as characterized by type, frequency, severity (as graded by NCI CTCAE v5.0), and timing., Predose and post dose concentrations of elranatamab., ADAs and NAbs against elranatamab., EORTC QLQ-C30 and MY20European Organisation for Research and Treatment of Cancer (EORTC) Core Quality of Life Questionnaire (QLQC30) and Myeloma Module 20 (MY20).

Source: https://euclinicaltrials.eu/ctis-public/view/2024-514139-50-00